EU clinical trial 2023-504150-35-00: Akynzeo as antiemetic treatment in patients with endometrial cancer treated with taxane - platinum combination chemotherapy. NOEME study.
Sponsor: Fondazione IRCCS Istituto Nazionale Dei Tumori (Hospital/Clinic/Other health care facility). Phase: Therapeutic use (Phase IV). Countries: Italy (ongoing, recruiting).
Therapeutic area(s): Diseases [C] - Pathological Conditions, Signs and Symptoms [C23]
Gender: Female. Age: 18-64 years, 65+ years. Enrolment: 84.
Status: Ongoing, recruiting. Start date (EU): 2024-02-21. Decision date: 2023-11-07. Results received: No. Last updated: 2025-12-01.

Condition(s): Endometrial cancer
Product: Ogivri 420 mg powder for concentrate for solution for infusion, KEYTRUDA 25 mg/mL concentrate for solution for infusion, IMFINZI 50 mg/mL concentrate for solution for infusion., Akynzeo 300 mg/0.5 mg hard capsules, Decadron “4 mg/1 ml Soluzione iniettabile”, JEMPERLI 500 mg concentrate for solution for infusion, Akynzeo 300 mg/0.5 mg hard capsules, IMFINZI 50 mg/mL concentrate for solution for infusion., Akynzeo 300 mg/0.5 mg hard capsules, Paclitaxel Kabi 6 mg/ml concentrato per soluzione per infusione, Tecentriq 1 200 mg concentrate for solution for infusion, Akynzeo 300 mg/0.5 mg hard capsules, CARBOPLATINO Pfizer 10 mg/ml soluzione per infusione, Ogivri 150 mg powder for concentrate for solution for infusion

Primary endpoint: Proportion of patients achieving complete response (CR: no emesis, no rescue medication) during the overall phase (0-120h) at cycle 1.
Endpoint(s): Proportion of patients achieving a complete response and complete control during the acute (0–24 h), delayed phase (>24 to 120 h) and overall (0-120h) phases of each cycle after the start of chemotherapy., Proportion of patients achieving no rescue medication, no emesis and no significant nausea (VAS score of <25 mm) during the acute (0-24 hours), delayed (>24 to 120 hours), and overall (0-120 hours) after the start of chemotherapy of each cycle., Proportion of patients achieving CR and complete control during the acute (0-24 hours), delayed (>24 to 120 hours), and overall (0-120 hours) phases after the start of each cycle according to Patient Emetogenicity Risk Profile assessed with 10 CINV Risk Assessment tool in patients with endometrial cancer receiving paclitaxel and carboplatin regimen with or without immunotherapy., The safety and tolerability of study drug (NEPA) will be evaluated based on AE reports, physical examination results (including vital signs), and clinical laboratory results by means of the occurrence, nature and severity of AEs.

Source: https://euclinicaltrials.eu/ctis-public/view/2023-504150-35-00